EU clinical trial 2025-522346-46-00: Study of Oral MC-1 for the Treatment of Patients with PNPO Deficiency
Protocol code: 16002
Sponsor: Medicure International Inc. (Pharmaceutical company). Phase: Therapeutic confirmatory (Phase III). Countries: Poland (ongoing, recruiting).
Therapeutic area(s): Diseases [C] - Nervous System Diseases [C10]
Gender: Female, Male. Age: 0-17 years, 18-64 years, 65+ years. Enrolment: 3.
Status: Ongoing, recruiting. Start date (EU): 2026-01-20. Decision date: 2025-11-21. Results received: No. Last updated: 2025-11-21.

Condition(s): Seizures associated with Pyridox(am)ine 5’-Phosphate Oxidase (PNPO) deficiency

Primary endpoint: Incidence of death at 12 months. The incidence of death at 12 months will be compared between the study group and an external control group (without any P5P treatment).
Endpoint(s): Frequency of seizures (including but not limited to status epilepticus)

Source: https://euclinicaltrials.eu/ctis-public/view/2025-522346-46-00